EU clinical trial 2024-510762-16-00: TACTI-003 (Two ACTive Immunotherapeutics): A multicenter, open label, randomized, Phase II trial to investigate a soluble LAG-3 fusion protein, eftilagimod alpha (efti; IMP321) in combination with pembrolizumab (PD-1 antagonist) for first line treatment of subjects with unresectable recurrent or metastatic squamous cell carcinoma of the head and neck (HNSCC)
Protocol code: TACTI-003
Sponsor: Immutep (Pharmaceutical company). Phase: Therapeutic exploratory (Phase II). Countries: Germany (ended), Spain (ended), Romania (ended), Denmark (ended), Belgium (ended).
Therapeutic area(s): Diseases [C] - Neoplasms [C04]
Gender: Female, Male. Age: 18-64 years, 65+ years. Enrolment: 127.
Status: Ended. Start date (EU): 2021-11-30. End date (EU): 2025-11-05. End date: 2025-11-06. Decision date: 2024-08-12. Results received: No. Last updated: 2025-07-07.
Decision dates by country: BE: 2024-08-13, DK: 2024-08-20, DE: 2024-08-13, RO: 2024-08-13, ES: 2024-08-12

Condition(s): Metastatic head and neck squamous cell carcinoma (HNSCC)
Product: KEYTRUDA 25 mg/mL concentrate for solution for infusion, IMP321

Primary endpoint: Objective response rate (ORR) according to RECIST1.1
Endpoint(s): Overall survival (OS), Objective response rate (ORR) according to iRECIST, Time to and duration of responses according to iRECIST and RECIST 1.1, Disease control rate according to iRECIST and RECIST 1.1, Progression free survival (PFS) according to iRECIST and RECIST 1.1, Occurrence of anti-efti-specific antibodies, Safety profile in terms of frequency, severity and duration of Adverse events (AEs) and serious adverse events (SAEs) and events of clinical interest (ECI) and abnormalities in vital signs, physical examination, 12- lead ECG and safety laboratory assessments, Quality of Life using EORTC QLQ-H&N43 and EORTC QLQ-30

Source: https://euclinicaltrials.eu/ctis-public/view/2024-510762-16-00